EU clinical trial 2023-506998-35-00: Phase III trial of lomustine/temozolomide (TMZ) combination therapy vs. standard TMZ therapy for newly diagnosed MGMT promoter methylated glioblastoma (IDHwt) patients +/- tumor treating fields (Optune)
Protocol code: TMZ-LOM
Sponsor: Vaestra Goetalandsregionen, Region Oestergoetland (Hospital/Clinic/Other health care facility). Phase: Therapeutic confirmatory (Phase III). Countries: Denmark (ongoing, recruiting), Norway (ongoing, recruiting), Sweden (ongoing, recruiting), Austria (ongoing, recruiting).
Therapeutic area(s): Diseases [C] - Neoplasms [C04]; Diseases [C] - Nervous System Diseases [C10]
Gender: Female, Male. Age: 18-64 years, 65+ years. Enrolment: 200.
Status: Ongoing, recruiting. Start date (EU): 2025-01-08. Decision date: 2024-04-04. Results received: No. Last updated: 2026-02-03.
Decision dates by country: AT: 2025-06-16, DK: 2024-04-04, SE: 2024-04-04, NO: 2024-04-09

Condition(s): Glioblastoma
Product: LOMUSTINE, TEMOZOLOMIDE

Primary endpoint: Overall survival (OS) as measured from the day of randomisation until death or follow-up of at least 36 months.
Endpoint(s): Progression-free survival (PFS) as measured from the day of randomisation until diagnosis of progressive disease determined by MRI (RANO 2.0 criteria), Best response rate determined by MRI (RANO 2.0 criteria), Frequency of delay of the next TMZ/LOM or TMZ cycle by more than 2 weeks, Acute toxicity during radiotherapy and chemotherapy +/- TTFields according to CTCAE latest available version at study start, Quality of life, determined by EORTC questionnaires QLQ-30 and BN-20, Evaluation of neurocognition determined by CNS Vital Signs, Frequency of pseudoprogression, Location of tumor recurrence in relation to radiotherapy isodose curves, Dose to hippocampus and healthy brain in relation to QoL and neurocognitive testing, Analysis of OS and PFS for the subgroup of patients receiving TTFields in relation to those not receiving TTFields per treatment arm and combined for both treatment arms (all TTFields patients versus all non-TTFields patients), Evaluation of neurocognition for the subgroup of patients receiving TTFields in relation to those not receiving TTFields per treatment arm and combined for both treatment arms (all TTFields patients versus all non-TTFields patients), Time to treatment failure, defined as premature stop of study treatment regardless of reason (progressive disease or toxicity), OS in relation to baseline comorbidities, Treatment related neurotoxicity evaluated on MRI

Source: https://euclinicaltrials.eu/ctis-public/view/2023-506998-35-00